EU clinical trial 2022-501910-79-01: A study of niraparib in combination with abemaciclib for late line treatment of ovarian cancer: a single center, open label, single arm, phase Ib/II trial (NICHOL TRIAL)
Sponsor: Fondazione IRCCS Istituto Nazionale Dei Tumori (Hospital/Clinic/Other health care facility). Phase: Phase I and Phase II (Integrated)- First administration to humans. Countries: Italy (ongoing, recruiting).
Therapeutic area(s): Diseases [C] - Neoplasms [C04]; Diseases [C] - Female Urogenital Diseases and Pregnancy Complications [C13]
Gender: Female. Age: 18-64 years, 65+ years. Enrolment: 73.
Status: Ongoing, recruiting. Start date (EU): 2024-09-18. Decision date: 2024-05-31. Results received: No. Last updated: 2026-06-25.

Condition(s): Ovarian cancer

Source: https://euclinicaltrials.eu/ctis-public/view/2022-501910-79-01